EU clinical trial 2024-518303-21-00: An open-label, randomised, multicentre, phase III study of irinotecan liposome injection, oxaliplatin, 5-fluorouracil/leucovorin versus nab-paclitaxel plus gemcitabine in subjects who have not previously received chemotherapy for metastatic adenocarcinoma of the pancreas
Protocol code: D-US-60010-001
Sponsor: Ipsen Bioscience Inc. (Pharmaceutical company). Phase: Therapeutic confirmatory (Phase III). Countries: Spain (ended).
Therapeutic area(s): Diseases [C] - Neoplasms [C04]
Gender: Female, Male. Age: 18-64 years, 65+ years. Enrolment: 3.
Status: Ended. Start date (EU): 2020-05-25. End date (EU): 2025-02-18. Decision date: 2024-10-17. Results received: Yes. Last updated: 2024-10-17.

Condition(s): Metastatic Pancreatic Adenocarcinoma
Product: Abraxane 5 mg/ml powder for dispersion for infusion., Onivyde pegylated liposomal 4.3 mg/ml concentrate for dispersion for infusion, Fluorouracil Accord 50 mg/ml šķīdums injekcijām vai infūzijām, CALCIUM FOLINATE, GEMCITABINE ACCORD 100 mg/ml, solution à diluer pour perfusion, Oxaliplatin Accord 5 mg/ml Konzentrat zur Herstellung einer Infusionslösung

Primary endpoint: The primary efficacy endpoint is the overall survival of subjects treated with irinotecan liposome injection +oxaliplatin+5 FU/LV compared to subjects treated with nab paclitaxel+gemcitabine.
Endpoint(s): Progression Free Survival, Overall Response Rate, The secondary efficacy endpoints (PFS and ORR) will only be evaluated if the primary efficacy endpoint demonstrates superiority for irinotecan liposome injection+oxaliplatin+5‑FU/LV over nab-‑ paclitaxel+gemcitabine.

Source: https://euclinicaltrials.eu/ctis-public/view/2024-518303-21-00